EU clinical trial 2023-506216-40-00: LUCY-1 - Letermovir/valganciclovir combination versus valganciclovir monotherapy for treatment of cytomegalovirus (CMV) infections in kidney transplant recipients
Protocol code: APHP220791
Sponsor: Assistance Publique Hopitaux De Paris (Hospital/Clinic/Other health care facility). Phase: Therapeutic confirmatory (Phase III). Countries: France (ongoing, recruiting).
Therapeutic area(s): Diseases [C] - Virus Diseases [C02]
Gender: Female, Male. Age: 18-64 years, 65+ years. Enrolment: 80.
Status: Ongoing, recruiting. Start date (EU): 2024-08-14. Decision date: 2023-11-21. Results received: No. Last updated: 2025-07-16.

Condition(s): CytoMegaloVirus infections, Kidney transplant
Product: PREVYMIS 240 mg film-coated tablets, Placebo of prevymis 240 mg tablets (letermovir), VALGANCICLOVIR

Primary endpoint: Virological response to treatment on Week-3, defined as a ≥ 2 log10 decrease of CMV DNAemia in whole blood from baseline, or an undetectable CMV DNAemia (< 200 IU/mL) in whole blood
Endpoint(s): Eradication of CMV DNAemia (< 200 IU/ml) before Week-12, detected in whole blood by quantitative CMV PCR every week until interruption of antiviral treatment, or at the latest until Week-12, Number of days between baseline and first measure of CMV DNAemia < 200 IU/mL in whole blood., Absence of CMV-related symptoms at baseline and each visit., Clinical side effects, neutrophil, platelet, hemoglobin, creatinine, liver enzymes, bilirubin, urea tested every week until interruption of antiviral treatment (or at the latest until Week-12), Tablet count at each visit, Sequencing of whole UL97, UL54, UL56, UL89 and UL51 genes in blood samples at baseline, Sequencing of UL97, UL54, UL56, UL89 and UL51 genes at Week-3 or Week-12 (in patients achieving criteria defining “treatment failure”), and at any visit in patients presented with rebound of CMV DNAemia., Measurement of ganciclovir (in both groups) and letermovir (in the bitherapy arm) trough plasma concentration (Cmin) at Week-1, Cmin and Cmax at Week-2, Measurement of the CMV specific T-cell immunity (by ELISpot-CMV) at baseline, Week-3, Week-6, Week-9 and Week-12.

Source: https://euclinicaltrials.eu/ctis-public/view/2023-506216-40-00